EU clinical trial 2023-503316-33-00: tislelizUMaB in canceR patients with molEcuLar residuaL disease (UMBRELLA)
Protocol code: 2023/3720 UMBRELLA
Sponsor: Institut Gustave Roussy (Hospital/Clinic/Other health care facility). Phase: Therapeutic confirmatory (Phase III). Countries: France (ongoing, recruiting).
Therapeutic area(s): Diseases [C] - Neoplasms [C04]; Diseases [C] - Digestive System Diseases [C06]; Diseases [C] - Respiratory Tract Diseases [C08]
Gender: Female, Male. Age: 18-64 years, 65+ years. Enrolment: 717.
Status: Ongoing, recruiting. Start date (EU): 2024-09-26. Decision date: 2024-03-29. Results received: No. Last updated: 2026-08-06.
Decision dates by country: FR: 2024-05-13

Condition(s): patients with a positive status for molecular residual disease (MRD) [MRD (+)] 2 to 5 months after the end of standard end of standard curative treatment
Product: Tislelizumab, CHLORURE DE SODIUM FRESENIUS 0,9 %, solution injectable

Primary endpoint: DFS for MRD (+) patients defined as the time from randomization to relapse or death, whichever occurs first. DFS rate will also be assessed at 12 months, 24 months, 48 months and 60 months.
Endpoint(s): DFS for MRD (-) patients defined as the time from randomization to relapse or death, whichever occurs first., OS defined as the time from randomization to death from any cause at 12, 24, 48 and 60 months., Percentage of MRD (+) subjects minimum 2 months and maximum 5 months after completion of standard curative-intent therapy, Time from detection of MRD to relapse at imaging as documented per RECIST v1.1., Percentage of subjects with MRD assessment failure., Time from baseline to detection of MRD (-) status in subjects who were MRD (+) at baseline, Incidence and severity of treatment-emergent adverse events (TEAEs) including all non-serious and serious AEs. Percentage of subjects with: i) TEAEs leading to dose interruptions ii) TEAEs leading to discontinuation, Scores from EORTC QLQ-C30 and EuroQol EQ-5D-5L questionnaires at baseline and at months 6, 12, 18 and 24., Incremental costs and QALY, ICER (€/QALY), INMB (cost effectiveness analysis), incremental costs (cost minimization analysis), Percentage of MRD (+) subjects with complete MR rates at 6 and 12 months in subjects starting systemic therapy with tislelizumab or placebo after curative-intent therapy, defined as patients with undetectable ctDNA at the time of analysis, Objective response rate and progression-free survival (PFS2) on the next line of therapy. (applicable for Arm A and B), Greenhouse gases emissions related to the intervention expressed in carbon dioxide equivalents (CO₂e).

Source: https://euclinicaltrials.eu/ctis-public/view/2023-503316-33-00